EU clinical trial 2025-520452-28-00: Fecal microbiota transfer for the secondary prevention of recurrent urinary tract infections in premenopausal women: a phase II trial (FEMITRANS)
Protocol code: FEMITRANS
Sponsor: Goethe University Frankfurt (Educational Institution). Phase: Therapeutic exploratory (Phase II). Countries: Germany (ongoing, recruiting).
Therapeutic area(s): Diseases [C] - Bacterial Infections and Mycoses [C01]
Gender: Female. Age: 18-64 years. Enrolment: 24.
Status: Ongoing, recruiting. Start date (EU): 2026-05-12. Decision date: 2025-05-22. Results received: No. Last updated: 2026-07-22.

Condition(s): Recurrent urinary tract infections (rUTI)
Product: Monuril 3000 mg Granulat, INTESTIFIX 001, Placebo to Vancomycin, MOVIPREP, Pulver zur Herstellung einer Lösung zum Einnehmen, Placebo to Fosfomycin, VANCOMYCIN, Placebo to INTESTIFIX 001

Primary endpoint: Rate of new UTI episodes within 180 days after treatment. A UTI for the endpoint assessment is defined as presence of at least one typical symptom (dysuria, alguria, pollakiuria or flank pain) in the absence of alternative causes plus the detection of a typical or potential uropathogen as defined by protocol by urinary culture.
Endpoint(s): Time to Post-FMT UTI: time to first UTI episode after treatment, Symptom burden: mean changes in ACSS score values on Day 7, 30, 90 and 180 compared to Baseline., Quality of Life: mean changes in score values on Day 30, 90 and 180 compared to Baseline, Number of new UTI episodes within 180 days after treatment caused by the same uropathogen as the last episode prior treatment, Antibiotic treatment frequency: Number of rUTI episodes treated with antibiotic until day 180, Vaginal infections: Number of episodes of bacterial vaginosis and/or candidosis until day 180, Assessment of safety: comparison of safety data between patients with or without FMT via review of nature, frequency and severity of adverse events (AEs), serious AEs (SAEs), and new medical conditions during six- month follow-up period

Source: https://euclinicaltrials.eu/ctis-public/view/2025-520452-28-00